EU clinical trial 2024-517139-29-00: Effects of DLX-001 on PD, Safety, Tolerability, and PK in Participants with MDD
Protocol code: DLX-001-102
Sponsor: Delix Therapeutics Inc. (Pharmaceutical company). Phase: Human Pharmacology (Phase I)- Other. Countries: Netherlands (ended).
Therapeutic area(s): Psychiatry and Psychology [F] - Mental Disorders [F03]
Gender: Female, Male. Age: 18-64 years. Enrolment: 20.
Status: Ended. Start date (EU): 2024-11-06. End date (EU): 2025-06-05. End date: 2025-06-06. Decision date: 2024-11-04. Results received: No. Last updated: 2025-05-27.

Condition(s): Major Depressive Disorder (MDD)

Source: https://euclinicaltrials.eu/ctis-public/view/2024-517139-29-00